EU clinical trial 2024-513951-33-00: Efficacy and safety of cannabidiol for pain relief of patients with end-stage metastatic castration resistant prostate cancer - a randomised double-blinded placebo-controlled phase II trial (ProCan)
Sponsor: Regionshospital Nordjylland (Hospital/Clinic/Other health care facility). Phase: Therapeutic exploratory (Phase II). Countries: Denmark (authorised, recruiting).
Therapeutic area(s): Diseases [C] - Neoplasms [C04]
Gender: Male. Age: 18-64 years, 65+ years. Enrolment: 58.
Status: Authorised, recruiting. Start date (EU): 2026-06-12. Decision date: 2025-04-29. Results received: No. Last updated: 2026-05-26.

Condition(s): Prostate cancer
Product: Cannabidiol, Placebo to Cannabidiol

Primary endpoint: Difference in average total daily dose of opioids (morphine milligram equivalents) during the trial participation with particular focus on the last week prior to end of trial (EOT) comparatively between study participants receiving CBD and placebo, respectively
Endpoint(s): Difference in average worst pain intensity on numeric rating scale (NRS) during the trial participation with particular focus on the last week prior to EOT comparatively between participants receiving CBD and placebo, respectively., Difference in interference of pain on daily functioning by Brief Pain Inventory during the trial participation with particular focus on the last week prior to EOT comparatively between participants receiving CBD and placebo, respectively.Short Form (BPI-SF) Interference Items, Difference in average total daily dose of non-opioid analgesics (e.g., NSAID, paracetamol, secondary analgesics) during the trial participation with particular focus on the last week prior to EOT comparatively between participants receiving CBD and placebo, respectively., Difference in use of concomitant therapy (e.g., radiation, corticosteroids) during the trial participation with particular focus on the last week prior to EOT comparatively between participants receiving CBD and placebo, respectively., Difference in quality of life by European Organization for Research and Treatment of Cancer Quality of Life Questionnaires Core 30 (EORTC-QLQ-C30) and European Organization for Research and Treatment of Cancer Quality of Life Prostate Cancer (EORTC-QLQ-PR25) during the trial participation with particular focus on the last week prior to EOT comparatively between participants receiving CBD and placebo, respectively., Difference in physical activity by average daily steps during the trial participation with particular focus on the last week prior to EOT comparatively between participants receiving CBD and placebo, respectively., Difference in tumour activity by average serum prostate-specific antigen (PSA) and alkaline phosphatase (ALP) levels during the trial participation with particular focus on the last week prior to EOT comparatively between participants receiving CBD and placebo, respectively., Difference in inflammation by average serum c-reactive protein (CRP), plasma cytokines and plasma soluble urokinase plasminogen activator receptor (suPAR) during the trial participation with particular focus on the last week prior to EOT comparatively between participants receiving CBD and placebo, respectively., Difference in safety profile outcomes by laboratory testing of routine blood samples and Common Terminology Criteria for Adverse Events (CTCAE 5.0) during the trial participation with particular focus on the last week prior to EOT comparatively between participants receiving CBD and placebo, respectively.

Source: https://euclinicaltrials.eu/ctis-public/view/2024-513951-33-00